EU clinical trial 2024-512600-19-00: A Phase 3, Randomized, Double-blind, Sham-controlled Study Investigating the Efficacy and Safety of GTX-102 in Pediatric Subjects with Angelman Syndrome
Protocol code: GTX-102-CL301
Sponsor: Ultragenyx Pharmaceutical Inc. (Pharmaceutical company). Phase: Therapeutic confirmatory (Phase III). Countries: Netherlands (ended), Spain (ongoing, recruitment ended), Germany (ongoing, recruitment ended), Poland (ongoing, recruitment ended).
Therapeutic area(s): Diseases [C] - Congenital, Hereditary, and Neonatal Diseases and Abnormalities [C16]
Gender: Female, Male. Age: 0-17 years. Enrolment: 40.
Start date (EU): 2025-04-14. Decision date: 2025-02-17. Results received: No. Last updated: 2026-07-15.
Decision dates by country: NL: 2025-02-24, ES: 2025-03-14, PL: 2025-03-16, DE: 2025-02-18

Condition(s): Angelman Syndrome
Product: GTX-102, GTX/UX Diluent and Flush Solution

Primary endpoint: Change from Baseline in Bayley-4 Cognitive Raw Score Without Caregiver Input at Day 338
Endpoint(s): Net Response in MDRI at Day 338, Change from Baseline in ABC-C Hyperactivity/Noncompliance Subscale Score at Day 338, Change from Baseline at Day 338 in Bayley-4 Receptive Communication raw score, Change from Baseline in ASA Sleep Rating Raw Score at Day 338, Number of Participants with Treatment Emergent Adverse Events (AEs) and Serious Adverse Events (SAEs), Severity of AEs and Relationship to Investigational Drug, Procedure, and Premedication, Changes from Baseline in Vineland Adaptive Behavior Scales-3 (Vineland-3) Receptive Communication raw score at Day 338, Changes from Baseline in Vineland-3 Expressive Communication raw score at Day 338, Changes from Baseline in Bayley-4 Gross Motor raw score at Day 338, Changes from Baseline in ASA Gross Motor rating at day 338

Source: https://euclinicaltrials.eu/ctis-public/view/2024-512600-19-00